EU clinical trial 2025-522340-40-00: I5T-MC-AACO: Global Study to Investigate Safety and Efficacy of Donanemab in Early Symptomatic Alzheimer’s Disease
Protocol code: I5T-MC-AACO
Sponsor: Eli Lilly & Co. (Pharmaceutical company). Phase: Therapeutic confirmatory (Phase III). Countries: Spain (ongoing, recruitment ended), Poland (ongoing, recruitment ended).
Therapeutic area(s): Diseases [C] - Nervous System Diseases [C10]
Gender: Female, Male. Age: 65+ years. Enrolment: 170.
Status: Ongoing, recruitment ended. Start date (EU): 2025-12-04. Decision date: 2025-10-30. Results received: No. Last updated: 2026-07-08.
Decision dates by country: ES: 2025-10-30, PL: 2025-10-31

Condition(s): Alzheimer Disease; Dementia; Brain Diseases; Central Nervous System Diseases; Nervous System Diseases; Tauopathies; Neurodegenerative Diseases; Neurocognitive Disorders; Mental Disorders
Product: Flortaucipir, SODIUM CHLORIDE PH. EUR., Flortaucipir F18, Florbetapir F18, FLORBETAPIR, Donanemab

Primary endpoint: Change from Baseline on the Integrated Alzheimer’s Disease Rating Scale (iADRS) in at least one of the low-medium tau pathology population or no-very low and low-medium tau pathology populations. [Time Frame: Baseline, Week 76]

Source: https://euclinicaltrials.eu/ctis-public/view/2025-522340-40-00